EU clinical trial 2023-506334-75-00: An Open-label Extension Study Evaluating the Long-term Safety and Efficacy of Seralutinib Orally Inhaled for the Treatment of Pulmonary Arterial Hypertension (PAH)
Protocol code: GB002-3102
Sponsor: GB002 Inc. (Pharmaceutical company). Phase: Therapeutic confirmatory (Phase III). Countries: Denmark (ongoing, recruitment ended), Poland (ongoing, recruitment ended), Lithuania (ongoing, recruitment ended), France (ongoing, recruitment ended), Ireland (ongoing, recruitment ended), Latvia (ongoing, recruitment ended), Netherlands (ended), Germany (ongoing, recruitment ended), Belgium (ongoing, recruitment ended), Austria (ended), Romania (ongoing, recruitment ended), Spain (ongoing, recruitment ended), Czechia (ongoing, recruitment ended), Greece (ongoing, recruitment ended), Portugal (ongoing, recruitment ended), Italy (ongoing, recruitment ended).
Therapeutic area(s): Diseases [C] - Cardiovascular Diseases [C14]
Gender: Female, Male. Age: 18-64 years, 65+ years. Enrolment: 128.
Start date (EU): 2024-07-12. Decision date: 2024-06-18. Results received: No. Last updated: 2026-04-30.
Decision dates by country: BE: 2024-06-19, RO: 2024-06-25, LT: 2024-06-21, AT: 2024-06-24, NL: 2024-06-24, IE: 2024-06-21, DK: 2024-06-18, LV: 2024-06-20, GR: 2024-06-21, IT: 2024-06-20, PL: 2024-06-24, PT: 2024-06-21, DE: 2024-06-19, CZ: 2024-06-18, ES: 2024-06-21, FR: 2024-08-23

Condition(s): Pulmonary Arterial Hypertension
Product: GB002

Primary endpoint: Incidence of treatment-emergent adverse events (TEAEs)
Endpoint(s): 1. Changes in distance achieved on the six-minute walk test (6MWT), (Δ6MWD), 2. Changes in NT-proBNP

Source: https://euclinicaltrials.eu/ctis-public/view/2023-506334-75-00